EU clinical trial 2025-523202-32-00: A Phase 3, Randomized, Double-blind, Placebo-Controlled, Multicenter Study to Evaluate Azetukalner in Moderate-to-Severe Major Depressive Disorder
Protocol code: XPF-010-D302
Sponsor: Xenon Pharmaceuticals Inc. (Pharmaceutical company). Phase: Therapeutic confirmatory (Phase III). Countries: Spain (authorised, recruiting), Czechia (not authorised), Slovakia (ongoing, recruiting), Romania (ongoing, recruiting), Poland (ongoing, recruiting), Finland (ongoing, recruiting), Germany (ongoing, recruiting).
Therapeutic area(s): Psychiatry and Psychology [F] - Mental Disorders [F03]
Gender: Female, Male. Age: 18-64 years, 65+ years. Enrolment: 162.
Start date (EU): 2026-02-26. Decision date: 2026-01-26. Results received: No. Last updated: 2026-07-10.
Decision dates by country: CZ: 2026-02-02, PL: 2026-01-30, SK: 2026-01-28, ES: 2026-02-02, FI: 2026-02-11, DE: 2026-05-12, RO: 2026-02-02

Condition(s): Major Depressive Disorder
Product: XPF-010, Placebo to match XPF-010

Primary endpoint: Change from baseline in the HAMD-17 score at Week 6.
Endpoint(s): Change from baseline in the SHAPS score at Week 6, Change from baseline in the HAMD-17 score at Week 1, Change from baseline in the CGI-S score at Week 6

Source: https://euclinicaltrials.eu/ctis-public/view/2025-523202-32-00